EU clinical trial 2024-511530-12-01: PeRsonalIzed MEdicine in Rheumatoid Arthritis (PRIMERA trial): a multicenter, open-label, randomized controlled trial comparing usual care with a tailor-made approach
Protocol code: PRIMERA001
Sponsor: Erasmus Universitair Medisch Centrum Rotterdam (Erasmus MC) (Hospital/Clinic/Other health care facility). Phase: Therapeutic use (Phase IV). Countries: Netherlands (ended).
Therapeutic area(s): Diseases [C] - Immune System Diseases [C20]
Gender: Female, Male. Age: 18-64 years, 65+ years. Enrolment: 300.
Status: Ended. Start date (EU): 2024-10-01. End date (EU): 2025-05-30. Decision date: 2024-10-01. Results received: No. Last updated: 2024-10-01.

Condition(s): Rheumatoid arthritis according to 2010 criteria
Product: Methotrexate 2,5 mg film-coated tablets, Simponi 50 mg solution for injection in pre-filled syringe., Hydroxychloroquine sulfate 200mg film-coated Tablets, Cimzia 200 mg solution for injection in pre-filled syringe, Depo-Medrol 80 mg/2 ml Injektionssuspension, Leflunomide Aurobindo 20 mg compresse rivestite con film, Enbrel 50 mg solution for injection in pre-filled syringe, Humira 40 mg solution for injection in pre-filled syringe, Sulfasalazine 500 mg Tablets, Jyseleca 200 mg film-coated tablets, Kenacort-A 40, suspensie voor injectie 40 mg/ml, Remicade 100 mg powder for concentrate for solution for infusion.

Primary endpoint: The primary outcomes for the clinical effectiveness consists of 2 parts, namely the difference in (1) proportion of patients using a b- or tsDMARD after 10 months of treatment and (2) disease activity, measured with the disease activity score (DAS) over time. The primary outcome for the cost-effectiveness analysis will be the incremental cost-effectiveness ratio (ICER), which is the ratio of the difference in costs to incremental benefits between both management approaches.
Endpoint(s): Disease activity (states) at 10 months, measured with the DAS., To investigate whether (changes in) biomarker(s) (levels) can adequately predict treatment response., Self-reported disease activity, measured with the Routine Assessment of Patient Index Data 3 (RAPID3)., Morning stiffness (severity and duration), measured with a 10-point Likert scale., General Health, measured with a visual analogue scale (VAS, 0 – 100 mm), Fatigue, measured with a visual analogue scale (VAS, 0 – 100 mm), Pain, measured with Generalized Pain Questionnaire(GPQ) and PainDetect., Functional ability, measured with the health assessment questionnaire (HAQ)., Quality of life, measured with the Dutch EuroQol questionnaire with 5 dimensions (EQ-5D) with 5 levels., Patient satisfaction, compliance and patient participation is respectively measured with the the Treatment Satisfaction Questionnaire for Medication (TSQM) and VAS, the Medication Adherence Report Scale (MARS-5) and the 9-Item Shared Decision Making Questionnaire (SDMQ9)., The Impact on Participation and Autonomy questionnaire (IPAQ) focuses on autonomy and participation of patients with chronic conditions., Worker productivity, measured with the Work Productivity and Activity Impairment (WPAI) questionnaire, which includes presentism and absenteeism.

Source: https://euclinicaltrials.eu/ctis-public/view/2024-511530-12-01